EU clinical trial 2024-517257-27-00: [68Ga]-FAPI PET/CT to detect fibroblast activity in non-resolving ARDS patients at the ICU.
Protocol code: 11304
Sponsor: Universitair Medisch Centrum Groningen (Hospital/Clinic/Other health care facility). Phase: Phase III and phase IV (Integrated). Countries: Netherlands (ongoing, recruiting).
Therapeutic area(s): Analytical, Diagnostic and Therapeutic Techniques and Equipment [E] - Diagnosis [E01]; Diseases [C] - Respiratory Tract Diseases [C08]
Gender: Female, Male. Age: 18-64 years, 65+ years. Enrolment: 20.
Status: Ongoing, recruiting. Start date (EU): 2024-11-24. Decision date: 2024-10-18. Results received: No. Last updated: 2024-10-18.

Condition(s): Non-resolving ARDS
Product: [68Ga]FAPI-46

Primary endpoint: [68Ga]FAPI uptake related to 28 days mortality, [68Ga]FAPI uptake related to ICU stay, [68Ga]FAPI uptake related to VFD-28
Endpoint(s): The relationship between pulmonary fibroblast activity, measured by FAPI-PET to clinically determined parameters of respiratory state (i.e. PEEP, Ppeak, lung compliance, driving pressure, mechanical power) and plasma markers of extracellular matrix and inflammation (e.g. IL-8/IL-6/TNFalpha and ProC3, C3M).2 Furthermore, we will perform a BAL to collect respiratory cytology and determine cellular phenotypes using scRNA., Evaluating PET/CT procedure using evaluation form and adverse event registration.

Source: https://euclinicaltrials.eu/ctis-public/view/2024-517257-27-00